EU clinical trial 2024-517128-21-02: A Randomized, Parallel-Group, Single-Attack, Open-Label Study to Evaluate the Efficacy of Diclofenac Potassium and Rimegepant for the Acute Treatment of Migraine (ATOM).
Sponsor: Rigshospitalet (Hospital/Clinic/Other health care facility). Phase: Therapeutic use (Phase IV). Countries: Denmark (ended).
Therapeutic area(s): Diseases [C] - Nervous System Diseases [C10]
Gender: Female, Male. Age: 18-64 years. Enrolment: 645.
Status: Ended. Start date (EU): 2022-05-04. End date (EU): 2025-04-30. Decision date: 2025-01-29. Results received: No. Last updated: 2025-01-29.

Condition(s): Migraine
Product: VOLTFAST 50 mg granulato per soluzione orale, VYDURA 75 mg oral lyophilisate

Primary endpoint: The percentage of subjects who become pain free at 2 hours(h) after treatment, before the use of any rescue medication is the primary measure of efficacy.
Endpoint(s): Absence of the most bothersome symptom (MBS) at 2 hours, Relapse, Headache intensity, Rescue medication, Global evaluation, Associated symptom – nausea, Associated symptom – photophobia, Associated symptom – phonophobia, Adverse events

Source: https://euclinicaltrials.eu/ctis-public/view/2024-517128-21-02